EU clinical trial 2024-515254-24-00: A study to investigate the safety, the amount that reaches the bloodstream and the effects on the body of JNJ-64619178 in people with advanced cancers
Protocol code: 64619178EDI1001
Sponsor: Janssen Cilag International (Pharmaceutical company). Phase: Human Pharmacology (Phase I)- First administration to humans. Countries: Spain (ended).
Therapeutic area(s): Diseases [C] - Neoplasms [C04]
Gender: Female, Male. Age: 18-64 years, 65+ years. Enrolment: 74.
Status: Ended. Start date (EU): 2018-11-08. End date (EU): 2025-09-25. End date: 2025-09-26. Decision date: 2024-08-28. Results received: No. Last updated: 2024-08-28.

Condition(s): Previously treated lymphoma (blood cancer) or solid tumors and NHL

Source: https://euclinicaltrials.eu/ctis-public/view/2024-515254-24-00